EU clinical trial 2022-500746-16-00: A Phase 2b, Randomized, Double-masked, Multicenter, Dose-ranging, Sham-controlled Clinical Trial to Evaluate Intravitreal JNJ-81201887 (AAVCAGsCD59) Compared to Sham Procedure for the Treatment of Geographic Atrophy (GA) Secondary to Age-related Macular Degeneration (AMD)
Protocol code: 81201887MDG2001
Sponsor: Janssen - Cilag International (Pharmaceutical company). Phase: Therapeutic exploratory (Phase II). Countries: Netherlands (ended), Belgium (ended), Germany (ended), Italy (ended), Portugal (ended), Sweden (ended), Hungary (ended), Poland (ended), Denmark (ended), Czechia (ended), Spain (ended).
Therapeutic area(s): Diseases [C] - Eye Diseases [C11]
Gender: Female, Male. Age: 18-64 years, 65+ years. Enrolment: 118.
Status: Ended. Start date (EU): 2023-08-11. End date (EU): 2026-02-19. End date: 2026-02-23. Decision date: 2023-07-17. Results received: No. Last updated: 2026-02-12.
Decision dates by country: IT: 2023-07-19, CZ: 2023-07-18, SE: 2023-07-21, PL: 2023-07-24, DE: 2023-07-19, ES: 2023-07-18, BE: 2023-07-19, PT: 2023-07-20, HU: 2023-07-24, NL: 2023-07-18, DK: 2023-07-17

Condition(s): Geographic Atrophy
Product: JNJ-81201887, Prednison acis 5 mg, Placebo to match Prednisone 20mg, 5mg, Prednison acis 20 mg, JNJ-81201887, Kenacort-A 40, suspensie voor injectie 40 mg/ml

Primary endpoint: Change in square root GA lesion area in the study eye measured on fundus autofluorescence (FAF)

Source: https://euclinicaltrials.eu/ctis-public/view/2022-500746-16-00